EU clinical trial 2023-509550-55-00: A Phase I/II, Randomized, Open-label Platform Study Utilizing a Master Protocol to Study Belantamab Mafodotin (GSK2857916) as Monotherapy and in Combination with Anti-Cancer Treatments in Participants with Relapsed/Refractory Multiple Myeloma (RRMM)–DREAMM5.
Protocol code: 208887
Sponsor: Glaxosmithkline Research & Development Limited (Pharmaceutical company). Phase: Phase I and Phase II (Integrated)- First administration to humans. Countries: Norway (ongoing, recruitment ended), Sweden (ended), France (ended), Poland (ongoing, recruitment ended).
Therapeutic area(s): Diseases [C] - Neoplasms [C04]
Gender: Female, Male. Age: 18-64 years, 65+ years. Enrolment: 62.
Start date (EU): 2020-01-21. Decision date: 2024-08-28. Results received: No. Last updated: 2026-06-04.
Decision dates by country: SE: 2024-08-28, FR: 2024-08-28, PL: 2024-08-30, NO: 2024-08-28

Condition(s): Multiple Myeloma
Product: Revlimid 25 mg hard capsules, Isatuximab, Revlimid 5 mg hard capsules, Dexa 8 mg inject JENAPHARM Injektionslösung, Revlimid 15 mg hard capsules, Zelvina 2.5 mg hard capsules, Dexa-ratiopharm® 8 mg Injektionslösung, Zelvina 10 mg hard capsules, Nirogacestat, Zelvina 5 mg hard capsules, Isatuximab, Dexamethason 8 mg JENAPHARM®, Zelvina 15 mg hard capsules, Nirogacestat, Imnovid 3 mg hard capsules, Revlimid 10 mg hard capsules, Imnovid 2 mg hard capsules, Revlimid 2.5 mg hard capsules, Dexamethason 8 mg GALEN® Tabletten, Zelvina 25 mg hard capsules, Imnovid 1 mg hard capsules, Imnovid 4 mg hard capsules, Fortecortin® 2 mg Tabletten

Primary endpoint: Dose Exploration: • Percentage (number) of participants with DLTs, Dose Exploration: • Percentage of participants with AEs, changes in clinical signs and laboratory parameters, Cohort Expansion: • ORR, according to the IMWG Response Criteria [Kumar, 2016]
Endpoint(s): Key Secondary end point Dose Exploration: • Clinical activity measured as ORR, according to IMWG Response Criteria, Secondary End points Dose Exploration: Rates of PR, VGPR, CR, sCR, Belantamab mafodotin observed concentrations, Anticancer combination observed concentrations, Incidence and titers of ADAs against belantamab mafodotin & combination treatments, Incidence of AEs of special interest for belantamab mafodotin and combination treatments, Incidence of ocular findings on ophthalmic exam, Secondary end points Cohort Expansion: CBR according to the IMWG Response Criteria [Kumar, 2016], PFS, DoR, TTR, Rates of: PR, VGPR; CR, sCR, OS, Incidence of AEs, SAEs, AEs leading to discontinuation or dose reduction/delay, changes in clinical signs, and laboratory parameters., Incidence of AESIs for belantamab mafodotin., Incidence of AESIs for the individual partner for each sub-study., Incidence of ocular findings on ophthalmic exam for belantamab mafodotin., Belantamab mafodotin and combination treatment’s plasma concentrations, Incidence and titers of ADAs against belantamab mafodotin and combination treatments, when measured

Source: https://euclinicaltrials.eu/ctis-public/view/2023-509550-55-00